EU clinical trial 2024-514458-61-01: NeoAdjuvant Dynamic marker - Adjusted Personalized Therapy comparing trastuzumab-deruxtecan versus pacli-/docetaxel+carboplatin+trastuzumab+pertuzumab in HER2+ early breast cancer (ADAPT-HER2-IV)
Protocol code: WSG-AM12
Sponsor: WSG Women's Cancer Study Group GmbH (Pharmaceutical company). Phase: Therapeutic exploratory (Phase II). Countries: Germany (ongoing, recruiting).
Therapeutic area(s): Diseases [C] - Neoplasms [C04]
Gender: Female. Age: 18-64 years, 65+ years. Enrolment: 705.
Status: Ongoing, recruiting. Start date (EU): 2024-02-05. Decision date: 2024-10-21. Results received: No. Last updated: 2026-07-20.

Condition(s): HER2+ early breast cancer
Product: TRASTUZUMAB DERUXTECAN

Primary endpoint: Proportion of patients with adverse drug reactions with CTCAE-grade 3 or higher, compared between patients treated with T-DXd neoadjuvant monotherapy for 18 weeks (part 1, cohort 2) and patients treated with SoC for 18 weeks (part 1 and 2, cohorts 2 and 3 pooled) H0: proportion in T-DXd 18 weeks (part 1, cohort 2) = proportion in SoC 18 weeks (part 1 and 2, cohorts 2 and 3 pooled) H1:proportion in T-DXd 18 weeks (part1,cohort 2)≠proportion in SoC 18weeks (part1 and 2, cohorts 2 and 3 pooled), 3-year dDFS (according to STEEP 2.0 criteria36) in patients with TDXd neoadjuvant monotherapy (pooled experimental treatment arms of part 1, pooled cohorts 1 and 2) H0: 3-year dDFS rate in the T-DXd pool (part 1, pooled cohorts 1 and 2) < 92.0% H1: 3-year dDFS rate in the T-DXd pool (part 1, pooled cohorts 1 and 2) ≥ 92.0%, 3-year dDFS (according to STEEP 2.0 criteria36) in patients with TDXd neoadjuvant therapy followed by CHT (pooled experimental treatment arms of part 2, cohort 3) H0: 3-year dDFS rate in the T-DXd - CHT pool (part 2, cohort 3) < 92.0% H1: 3-year dDFS rate in the T-DXd - CHT pool (part 2, cohort 3) ≥ 92.0%, Prespecified endpoint for part 1 (pooled cohorts 1 and 2): pCR (defined as ypTis/ypN0) rate, compared between patients treated with T-DXd neoadjuvant monotherapy (pooled experimental treatment arms of part 1, pooled cohorts 1 and 2) compared to patients of corresponding standard-of-care treatments (DOC/PAC+T+P or DOC/PAC+Carbo+T+P) (pooled SoC treatment arms of part1, pooled cohorts1and2) H0:pCR T-DXd=pCR SoC in part1 (pooled cohorts1and2) H1:pCR T-DXd≠pCR SoC in part1 (pooled cohorts1and2)
Endpoint(s): 3-year dDFS (according to STEEP 2.0 criteria36) compared between patients treated with T-DXd neoadjuvant monotherapy for a different time and different following therapies (the 4 specific compared treatment could not be enter here due to lack of space. Please see protocol for complete and detailed information), 3-year dDFS in patients with pCR after neoadjuvant treatment without further chemotherapy: It should be tested whether 3-year dDFS exceeds 93% (literature data), 3-year dDFS in patients treated with neoadjuvant T-DXd: It should be tested whether 3-year dDFS of each arm exceeds 92% (literature data), pCR (defined as ypTis/ypN0) rates compared between patients treated with T-DXd neoadjuvant monotherapy for a different time and different following therapies (the 4 specific compared treatments could not be entered here due to lack of space. Please see protocol for complete and detailed information), Proportion of patients with clinical response at 6, 12 and 24 weeks of neoadjuvant treatment compared between T-DXd treated patients and SoC treated patients as stated above, Further 3-year survival endpoints according to STEEP 2.0 criteria (iDFS, OS, LRFS, BCFS, DRFI) to be compared between T-DXd treated patients and SoC treated patients as stated above

Source: https://euclinicaltrials.eu/ctis-public/view/2024-514458-61-01